EU clinical trial 2024-513455-33-00: REGOBONE_A Randomized Phase II, placebo-controlled, multicenter study evaluating efficacy and safety of regorafenib in patients with metastatic bone sarcomas
Protocol code: UC-0150/1309
Sponsor: Unicancer (Hospital/Clinic/Other health care facility). Phase: Therapeutic exploratory (Phase II). Countries: France (ended).
Therapeutic area(s): Diseases [C] - Neoplasms [C04]
Gender: Female, Male. Age: 0-17 years, 18-64 years, 65+ years. Enrolment: 163.
Status: Ended. Start date (EU): 2014-09-11. End date (EU): 2025-09-03. Decision date: 2024-08-09. Results received: Yes. Last updated: 2026-07-31.

Condition(s): Bone sarcoma
Product: Stivarga 40 mg film-coated tablets

Primary endpoint: The primary efficacy endpoint is the non-progression rate at 8 weeks for osteosarcoma, Ewing sarcoma and CIC-rearranged sarcoma patients, at 12 weeks for chondrosarcoma patients and at 6 months for chordoma patients. The non-progression rate will be defined as the proportion of patients without disease progression at the defined timepoint after confirmation by central radiological review (using RECIST 1.1).
Endpoint(s): Progression-Free Survival [defined using RECIST 1.1] will be measured from the date of randomization or start of treatment for cohort E until the date of radiological progression or death whatever the cause (if death occurs before progression)., Objective response rate [defined as complete response (CR) or partial response (PR) according to RECIST 2009, version 1.1, for all cohorts, and CHOI criteria for chordoma] ;, Disease control rate at 6 months (defined as the proportion of patients who a best response rating of CR, PR or stable disease [SD]), SD should be at least 8 weeks ;, Overall survival (defined as the time from the date of randomization or start of treatment for cohort E until the date of death due to any cause); if the patients is alive at the date of data base cut off then he will be censored at the data base cut off date;, Duration of response (defined as the time from date of first documented objective response of CR or PR, whichever is noted earlier, to first disease progression or death before progression ;, Progression-free rate at 3 and 6 months (PFR-3 and PFR-6), defined as the proportion of patients without progression at 3 and 6 months post randomization or start of treatment for cohort E;, Time to progression (measured from date of randomization or start of treatment for cohort E until the date of first observation of progression );, Growth Modulation Index (GMI) defined as ratio of time to PD under regorafenib to TTP under previous treatment. The GMI will be explored in patients receiving regorafenib after randomization or start of treatment for cohort E;, Identification and characterization of biomarkers, Toxicity according to NCI-CTC V4.0, Pain assessment for chordomas, Progression Free Survival according to CHOI criteria for chordomas All efficacy assessments using CHOI criteria (only for chordomas) will be performed by central radiological reviewers.

Source: https://euclinicaltrials.eu/ctis-public/view/2024-513455-33-00